EU clinical trial 2025-521941-25-00: Ipilimumab and nivolumab plus temozolomide and capecitabine for patients with chemo-refractory pMMR, MGMT silenced metastatic colorectal cancer: The MAYA2 trial
Sponsor: Odense University Hospital (Hospital/Clinic/Other health care facility). Phase: Therapeutic exploratory (Phase II). Countries: Denmark (authorised, recruitment pending).
Therapeutic area(s): Diseases [C] - Neoplasms [C04]
Gender: Female, Male. Age: 18-64 years, 65+ years. Enrolment: 165.
Status: Authorised, recruitment pending. Decision date: 2025-09-19. Results received: No. Last updated: 2026-05-18.

Condition(s): Colorectal cancer
Product: TEMOZOLOMIDE, TEMOZOLOMIDE, TEMOZOLOMIDE, IPILIMUMAB, TEMOZOLOMIDE, CAPECITABINE, TEMOZOLOMIDE, NIVOLUMAB, TEMOZOLOMIDE, CAPECITABINE

Primary endpoint: Disease control rate (DCR) (complete response (CR), PR, or SD) evaluated by a CT scan 16 weeks after initiation of TemCap.
Endpoint(s): 1. PFS for patients initiating TemCap and for patients initiating TemCap with ipi-nivo, 2. OS for patients initiating TemCap and for patients initiating TemCap with ipi-nivo, 3. ORR according to RECIST 1.1 criteria, 4. Safety and tolerability of the combination of ipi-nivo and TemCap, 5. Quality of life measured by the EORCT QLQ-C30 questionnaire

Source: https://euclinicaltrials.eu/ctis-public/view/2025-521941-25-00